EU clinical trial 2024-519165-22-00: A study to find out whether the medication pasireotide is absorbed and processed the same way when given under the skin using either a reusable pen or a syringe in healthy subjects
Protocol code: SOM230-RECAG-PK-0605
Sponsor: Recordati AG (Pharmaceutical company). Phase: Human Pharmacology (Phase I)- Other. Countries: Germany (ended).
Therapeutic area(s): Diseases [C] - Nutritional and Metabolic Diseases [C18]
Gender: Female, Male. Age: 18-64 years. Enrolment: 40.
Status: Ended. Start date (EU): 2025-11-04. End date (EU): 2026-02-03. Decision date: 2025-07-10. Results received: No. Last updated: 2026-01-13.

Condition(s): Post-bariatric hypoglycaemia

Source: https://euclinicaltrials.eu/ctis-public/view/2024-519165-22-00